EU clinical trial 2024-515189-14-00: Quercus ilex and Quercus robur allergen extracts. Determination of in the vivo histamine equivalent prick test units (HEP).
Protocol code: T525-STD-043
Sponsor: Inmunotek S.L. (Pharmaceutical company). Phase: Therapeutic exploratory (Phase II). Countries: Spain (ended).
Therapeutic area(s): Diseases [C] - Immune System Diseases [C20]
Gender: Female, Male. Age: 18-64 years. Enrolment: 30.
Status: Ended. Start date (EU): 2023-01-26. End date (EU): 2025-01-28. Decision date: 2024-10-03. Results received: Yes. Last updated: 2024-10-03.

Condition(s): Allergy to Quercus ilex and Quercus robur
Product: Prick test of Quercus robur allergen extract, Prick test of Quercus ilex allergen extract, Skin Prick Test Negative control, Skin Prick Test Positive control

Primary endpoint: The primary and single variable is the size of the induced skin papule on application of each of the concentrations of the allergenic extracts and of the positive (histamine) and negative controls, using the prick test.

Source: https://euclinicaltrials.eu/ctis-public/view/2024-515189-14-00